EU clinical trial 2025-522233-62-00: A multi-center, open-label Phase 1/2 study to evaluate the safety, efficacy, PK and PD of ONA-255 in study participants with advanced cancer
Protocol code: ONA-255-101
Sponsor: Ona Therapeutics S.L. (Pharmaceutical company). Phase: Phase I and Phase II (Integrated)- First administration to humans. Countries: Spain (ongoing, recruiting).
Therapeutic area(s): Diseases [C] - Neoplasms [C04]
Gender: Female, Male. Age: 18-64 years, 65+ years. Enrolment: 117.
Status: Ongoing, recruiting. Start date (EU): 2025-12-12. Decision date: 2025-11-19. Results received: No. Last updated: 2025-11-19.

Condition(s): Advanced cancer; breast cancer; metastatic gastric / gastroesophageal junction cancer

Primary endpoint: Phase 1a: Number and proportion of participants who experience at least 1 dose limiting toxicity (DLT) as confirmed by SMC based on incidence, nature, and severity of TEAEs, and SAEs graded according to NCI CTCAE v5.0 as well as on changes from baseline in physical examination, vital signs, and clinical laboratory tests during the first 21-day cycle. MBAD (first evaluable response to treatment with ONA-255 – either ctDNA decline or RECIST tumour response – whatever is occurring at a lower dose), Phase 1a (cont.): MBAD (first evaluable response to treatment with ONA-255 – either ctDNA decline or RECIST tumour response – whatever is occurring at a lower dose), Phase 1b: Safety and tolerability of ONA-255 monotherapy as assessed by Treatment Related Adverse Events (TRAE), drug interruptions, dose reductions and treatment discontinuations under consideration of preliminary antitumor data, Phase 2a: Investigator-assessed ORR defined as the proportion of study participants with a best overall response of complete (CR) or partial (PR) response as per the Response Evaluation Criteria in Solid Tumors (RECIST) version 1.1 (Eisenhauer at al., 2009)
Endpoint(s): Safety: Incidence of SAEs - Incidence of TEAEs and TRAEs - Rate of treatment modification (dose interruption, dose reductions) and treatment discontinuations - Changes in clinical laboratory measures with laboratory abnormal graded according to NCT-CTCAE version 5.0 - Clinically significant changes in physical examination - Changes in vital signs (blood pressure, respiratory rate and temperature), Safety (cont.): Changes in ECOG performance status - Changes in 12-lead ECGs to evaluate the heart rate, atrial ventricular conduction, QTcF, and arrhythmias, Efficacy: - Investigator assessed ORR (CR + PR) for entire study using RECIST 1.1 response criteria - Clinical Benefit rate (CBR) (CR + PR + SD ≥ 6 months) for entire study / RP2D - Time to Response for entire study / RP2D - Duration of Response (DoR) (CR + PR) for entire study / RP2D, Efficacy (cont.): - PFS for entire study / RP2D - PFS2 (time from enrolment/randomisation to this study to objective disease progression under subsequent treatment, or death from any cause, whichever is first), Immunogenicity: - ADA prevalence and incidence Titre and neutralizing antibodies will be determined when -- ADA is positive, Pharmacokinetic Cycle 1 and/or Cycle 3: Cmax, Ctrough, tmax, AUC(0-last), AUC(0-504), AUC(0 inf) (Cycle 1 only), CL (for MMAE: CL/F), Vss (for MMAE: Vz/F), t1/2, Exploratory Endpoints: - Tumour tissue: FGFR4 expression (IHC, mRNA as part of RNADX assessment) - Tumour tissue: molecular subtype by PAM50 assay and other genomic signatures (RNA) - Tumour tissue: ESR1/PIK3CA/TP53/RB1 mutation status (DNA sequencing) - Tumour tissue and plasma (DNA): DNADX subtypes and signatures, including, eg, ER signaling, RB-LOH; for plasma also tumour fraction (ctDNA), Exploratory Endpoints (cont.): - Tumour tissue: HER2 status (IHC) - Tumour tissue: implantation of fresh patient-derived tumour tissue in an animal model to study the mechanism of response and resistance to ONA-25

Source: https://euclinicaltrials.eu/ctis-public/view/2025-522233-62-00